EU clinical trial 2024-514191-41-00: A randomized, double-blind, placebo-controlled proof-of-concept parallel group clinical trial to investigate the efficacy, safety and tolerability of weekly subcutaneous (SC) dosing of CK-0045 in participants with overweight / obesity and Type 2 diabetes
Protocol code: CK-0045_CS02
Sponsor: Cytoki Pharma ApS (Pharmaceutical company). Phase: Therapeutic exploratory (Phase II). Countries: Germany (ended).
Therapeutic area(s): Diseases [C] - Nutritional and Metabolic Diseases [C18]
Gender: Female, Male. Age: 18-64 years, 65+ years. Enrolment: 90.
Status: Ended. Start date (EU): 2024-09-16. End date (EU): 2025-10-21. Decision date: 2024-09-10. Results received: Yes. Last updated: 2025-07-15.

Condition(s): Type 2 diabetes and Obesity
Product: non-preserved sterile liquid formulation

Primary endpoint: Change from baseline in area under the plasma glucose (PG) curve after a MMTT (AUCPG0- 4h) after 16 weeks of treatment.
Endpoint(s): Change from baseline in body weight, total cholesterol, HDL-, LDL-cholesterol, triglycerides, free fatty acids (FFA), Lp(a), and HbA1c after 16 weeks of treatment.

Source: https://euclinicaltrials.eu/ctis-public/view/2024-514191-41-00